EU clinical trial 2024-516602-28-00: A Phase 1/2 Study of BMS-986482 as Monotherapy or Combination Therapy in Participants with Advanced Solid Tumors
Protocol code: CA2360001
Sponsor: Bristol-Myers Squibb Services Unlimited Company (Pharmaceutical company). Phase: Phase I and Phase II (Integrated)- First administration to humans. Countries: Belgium (ongoing, recruiting), Netherlands (ongoing, recruiting), Denmark (ongoing, recruiting), Greece (authorised, recruitment pending), Italy (ongoing, recruiting), Sweden (ongoing, recruiting), France (ongoing, recruiting), Spain (authorised, recruitment pending).
Therapeutic area(s): Diseases [C] - Neoplasms [C04]
Gender: Female, Male. Age: 18-64 years, 65+ years. Enrolment: 62.
Start date (EU): 2025-11-21. Decision date: 2025-08-18. Results received: No. Last updated: 2026-05-08.
Decision dates by country: SE: 2025-08-25, FR: 2025-08-19, ES: 2025-09-19, BE: 2025-08-21, DK: 2025-08-18, IT: 2025-08-18, GR: 2025-08-20, NL: 2025-08-20

Condition(s): Advanced Solid Tumors
Product: Nivolumab Subcutaneous, BMS986482, FDC Nivolumab + Relatlimab + rHuPH20 Injection, BMS986482, BEVACIZUMAB

Primary endpoint: To evaluate the incidence of adverse events (AEs), serious adverse events (SAEs), AEs meeting protocol-defined dose limiting toxicity (DLT) criteria, AEs leading to discontinuation, and death up to safety follow-up visit occurs.
Endpoint(s): To include a summary of the exposure levels of the study drug up to the last pharmacokinetics sampling time point., To evaluate the overall response rate (ORR) up to last tumor assessments until disease progression or death.

Source: https://euclinicaltrials.eu/ctis-public/view/2024-516602-28-00